EU clinical trial 2023-506841-52-00: Open-Label Safety and Efficacy Study of Cenobamate (YKP3089) in Pediatric Subjects with Partial-onset (Focal) Seizures
Protocol code: YKP3089C040
Sponsor: Sk Life Science Inc. (Pharmaceutical company). Phase: Therapeutic confirmatory (Phase III). Countries: Germany (ongoing, recruitment ended), Hungary (ongoing, recruitment ended), Poland (ongoing, recruitment ended), Spain (ongoing, recruitment ended).
Therapeutic area(s): Diseases [C] - Nervous System Diseases [C10]
Gender: Female, Male. Age: 0-17 years. Enrolment: 74.
Status: Ongoing, recruitment ended. Start date (EU): 2023-03-22. Decision date: 2024-04-25. Results received: No. Last updated: 2025-11-14.
Decision dates by country: DE: 2024-04-26, HU: 2024-04-26, PL: 2024-04-29, ES: 2024-04-25

Condition(s): partial-onset (focal) seizures
Product: Cenobamate 25mg, Cenobamate 10mg/mL, Cenobamate 12.5mg, Cenobamate 50mg, Cenobamate 100mg

Primary endpoint: Number of participants with any treatment-emergent adverse event (TEAE) and any serious adverse event (SAE) during the first year of exposure
Endpoint(s): Percent change in seizure frequency over 28 days during the Treatment Period and during each phase of the study, Number of participants who are seizure-free during the Treatment Period and during each phase of the study, Percentage of responders (50%, 75%, and 90% responders) during the Treatment Period and during each phase of the study, Change from Baseline in A-B neuropsychological assessment schedule (ABNAS) end of titration, end of maintenance and 52 weeks, Change from Baseline in Child Behavior Checklist (CBCL) scores end of titration, end ofmaintenance and 52 weeks, Change from Baseline in Lafayette Grooved Pegboard Test (LGPT) scores end of titration, end of maintenance and 52 weeks, Change from Baseline in height, Change from Baseline in weight, Percentage of participants with any treatment-emergent reports of suicidal ideation and behavior assessed using the Columbia-Suicide Severity Rating Scale (C-SSRS) during treatment (adult version for 12-18 year olds; Pediatric version for 6-11 year olds) 32, Acceptability and palatability assessment (determined by a 5-point Hedonic Scale) of the oral suspension and tablets Visit 2 and Visit 3.

Source: https://euclinicaltrials.eu/ctis-public/view/2023-506841-52-00